EU clinical trial 2024-511054-50-00: An Operationally Seamless Phase 2/3, Randomized, Active -Controlled Study Evaluating the Safety and Efficacy of an Oral Weekly Regimen of GS-1720 in Combination With GS-4182 Versus Biktarvy in Virologically Suppressed People With HIV-1
Protocol code: GS-US-695-6509
Sponsor: Gilead Sciences Inc. (Pharmaceutical company). Phase: Phase II and Phase III (Integrated). Countries: France (authorised, recruitment pending), Germany (authorised, recruitment pending), Poland (authorised, recruitment pending), Sweden (authorised, recruitment pending), Spain (authorised, recruitment pending), Italy (authorised, recruitment pending).
Therapeutic area(s): Diseases [C] - Virus Diseases [C02]
Gender: Female, Male. Age: 18-64 years, 65+ years. Enrolment: 35.
Status: Authorised, recruitment pending. Decision date: 2025-02-13. Results received: No. Last updated: 2025-04-02.
Decision dates by country: FR: 2025-02-13, DE: 2025-02-18, IT: 2025-02-18, ES: 2025-02-17, SE: 2025-02-17, PL: 2025-02-24

Condition(s): HIV-1 Infection
Product: GS-1720, Biktarvy 50 mg/200 mg/25 mg film-coated tablets, GS-4182

Primary endpoint: Phase 2: The proportion of participants with HIV-1 RNA ≥ 50 copies/mL at Week 24 as determined by the United States (US) Food and Drug Administration (FDA)-defined snapshot algorithm, Phase 3: The proportion of participants with HIV-1 RNA ≥ 50 copies/mL at Week 48 as determined by the US FDA-defined snapshot algorithm
Endpoint(s): Phase 2: The proportion of participants with HIV-1 RNA ≥ 50 copies/mL at Weeks 12 and 48 as determined by the US FDA-defined snapshot algorithm, Phase 2: The proportion of participants with HIV-1 RNA < 50 copies/mL at Weeks 12, 24, and 48 as determined by the US FDA-defined snapshot algorithm, Phase 2: The change from baseline in CD4+ T-cell count at Weeks 12, 24, and 48, Phase 2: The proportion of participants experiencing treatment-emergent adverse events (TEAEs), and treatment-emergent laboratory abnormalities through Weeks 12, 24, and 48, Phase 2: PK parameters (Cmax, Tmax, Ctau, and AUCtau, as applicable) of GS-1720 and lenacapavir (LEN), Phase 3: The proportion of participants with HIV-1 RNA ≥ 50 copies/mL at Week 96 as determined by the US FDA-defined snapshot algorithm, Phase 3: The proportion of participants with HIV-1 RNA < 50 copies/mL at Weeks 48 and 96 as determined by the US FDA-defined snapshot algorithm, Phase 3: The change from baseline in CD4+ T-cell count at Weeks 48 and 96, Phase 3: The proportion of participants experiencing TEAEs, and treatment-emergent laboratory abnormalities through Weeks 48 and 96

Source: https://euclinicaltrials.eu/ctis-public/view/2024-511054-50-00